EU clinical trial 2023-504610-30-01: Modified autologous leukocyte cells for the treatment of acute kidney injury after cardiac surgery
Protocol code: M2R.AKI.2021
Sponsor: M2rlab S.L. (Pharmaceutical company). Phase: Therapeutic exploratory (Phase II). Countries: Spain (ongoing, recruiting).
Therapeutic area(s): Diseases [C] - Female Urogenital Diseases and Pregnancy Complications [C13]; Diseases [C] - Male Urogenital Diseases [C12]
Gender: Female, Male. Age: 18-64 years, 65+ years. Enrolment: 98.
Status: Ongoing, recruiting. Start date (EU): 2026-04-29. Decision date: 2024-08-14. Results received: No. Last updated: 2026-02-26.

Condition(s): Acute kidney injury after cardiac surgery
Product: Mononuclear cells M2RLAB, Suero fisiológico (NaCl 0,9%)

Primary endpoint: Renal function recovery time, Proportion of patients with no persistently altered creatinine values (>31% of baseline values) 7 days after AKI episode, Occurrence of adverse events (AEs), serious AEs (SAEs), AEs resulting in discontinuation of study treatment, AEs of special interest
Endpoint(s): Reducing the incidence of MAKE ** **MAKE (major adverse kidney events): death, dialysis, or permanent reduction in estimated glomerular filtration rate (CKD-EPI) of >30% of baseline value., Number of patients on renal replacement therapy and duration of therapy, Duration of ICU admission (days). Duration (days) of hospital stay of the patients, Global survival at 30 days. Global survival at 90 days., Global survival at 30 days. Number of patients on dialysis at 30 days. Global survival at 90 days. Number of patients on dialysis at 90 days, Maximum creatinine values (peak creatinine) recorded during the patients' hospitalisation and time (days) when the maximum peak occurs, Improved levels of injury biomarkers in urine, Patients presenting: Surgical wound infections; Respiratory infections during ICU stay, Complications related to surgery: Sternotomy; Re-intervention; Circulatory support, Unexplained hemodynamic impairment: - Drop in cardiac index to <2.5 L/min/m2 (if previously higher) and/or - Drop in systemic systolic blood pressure >30% or <90 mmHg and/or Increased dose of vasoactive drugs > 30%

Source: https://euclinicaltrials.eu/ctis-public/view/2023-504610-30-01